EU clinical trial 2024-518207-22-00: A Phase 2, Open-label, Multicenter Study to Assess the Efficacy and Safety of BW-20805 in Adult Subjects with Hereditary Angioedema
Protocol code: BW-20805-2001
Sponsor: Shanghai Argo Biopharmaceutical Co. Ltd. (Pharmaceutical company). Phase: Therapeutic exploratory (Phase II). Countries: Spain (ongoing, recruitment ended), Poland (ended), Italy (ongoing, recruitment ended), Germany (ongoing, recruitment ended).
Therapeutic area(s): Diseases [C] - Congenital, Hereditary, and Neonatal Diseases and Abnormalities [C16]
Gender: Female, Male. Age: 18-64 years, 65+ years. Enrolment: 10.
Start date (EU): 2025-05-15. Decision date: 2025-04-07. Results received: No. Last updated: 2025-10-29.
Decision dates by country: ES: 2025-04-10, IT: 2025-04-09, DE: 2025-04-07, PL: 2025-04-22

Condition(s): Hereditary Angioedema
Product: BW-20805 Injection

Primary endpoint: Change from baseline in time normalized monthly (per 4 weeks) HAE attack rate over Days 29-169.
Endpoint(s): Incidence and severity of SAEs and AEs during the main study period, extension study period and whole study., Change from baseline in timenormalized monthly (per 4 weeks) HAE attack rate to Day 169., Change from baseline in time-normalized monthly (per 4 weeks) HAE attack rate during the main study period and extension period., Change from baseline in plasma PKK concentration during the main study period and extension period.

Source: https://euclinicaltrials.eu/ctis-public/view/2024-518207-22-00